EU clinical trial 2024-517708-12-00: Effect of early dexamethasone on major complications and all-cause mortality in severe burns
Protocol code: RC24_0442
Sponsor: Centre Hospitalier Universitaire De Nantes (Hospital/Clinic/Other health care facility). Phase: Therapeutic confirmatory (Phase III). Countries: France (ongoing, recruiting).
Therapeutic area(s): Analytical, Diagnostic and Therapeutic Techniques and Equipment [E] - Anesthesia and Analgesia [E03]
Gender: Female, Male. Age: 18-64 years, 65+ years. Enrolment: 478.
Status: Ongoing, recruiting. Start date (EU): 2025-11-07. Decision date: 2025-04-18. Results received: No. Last updated: 2025-04-18.

Condition(s): Severe burns
Product: SODIUM CHLORIDE, DEXAMETHASONE PHOSPHATE

Primary endpoint: Hierarchical endpoints: - Major complications defined as moderate to severe ARDS (using Berlin definition criteria) or AKI KDIGO 2 to 3 within 28 days - All-cause mortality at day 90 On the basis of a hierarchical testing plan, the primary endpoints will be tested sequentially for superiority. First we will test for superiority on major complications. If positive, we will test for superiority on all-cause mortality.
Endpoint(s): Hospital-acquired infections: ● Hospital-acquired pneumonia (using the joint definition from the Infectious Diseases Society of America and American Thoracic Society) within 28 days ● Catheter-related bloodstream infections within 28 days ● other infections, including skin infections (diagnosis confirmed by an independent adjudication committee) with or without bacteraemia within 28 days ● Antibiotic-free days on day 28, Respiratory complications: ● ARDS (using Berlin Criteria definition) on day 28 ● Invasive ventilator-free days on day 28, ICU LOS and Hospital LOS, SOFA scores on day 1, day 3, day 7 and day 14, KDIGO stages 2 and 3 AKI within 28 days, General tolerance within day 28: ● hyperglycemia, ● hypernatremia, ● hypokalaemia, ● gastrointestinal bleeding, ● acquired-weakness, Specific tolerance within 28 days: ● surgical site infections confirmed by an independent adjudication committee, ● autograft failures, Serum CRP levels on day 0, day 1, day 3, day 7 and day 14, Timing of first surgery

Source: https://euclinicaltrials.eu/ctis-public/view/2024-517708-12-00